EU clinical trial 2023-506184-34-00: An open label, multicenter extension study in patients previously enrolled in a Genentch and/or F. Hoffmann-La Roche Ltd sponsored atezolizumab study (IMBRELLA B)
Protocol code: BO40729
Sponsor: F. Hoffmann-La Roche AG (Pharmaceutical company). Phase: Therapeutic confirmatory (Phase III). Countries: Spain (ongoing, recruitment ended), Hungary (ended), Slovakia (ended), Poland (ongoing, recruitment ended), Romania (ended), Latvia (ongoing, recruitment ended), Czechia (ongoing, recruitment ended), Belgium (ongoing, recruitment ended), Greece (ongoing, recruitment ended), Germany (ongoing, recruitment ended), France (ongoing, recruitment ended).
Therapeutic area(s): Diseases [C] - Neoplasms [C04]
Gender: Female, Male. Age: 18-64 years, 65+ years. Enrolment: 104.
Start date (EU): 2019-08-09. Decision date: 2024-07-08. Results received: No. Last updated: 2026-04-30.
Decision dates by country: HU: 2024-07-08, SK: 2024-07-08, DE: 2024-07-09, LV: 2024-07-08, ES: 2024-07-15, BE: 2024-07-10, CZ: 2024-07-10, PL: 2024-07-18, GR: 2024-09-17, RO: 2024-07-30, FR: 2024-07-11

Condition(s): Advanced Malignancies
Product: Sutent 50 mg hard capsules, Alectinib (Alecensa), Sutent 12.5 mg hard capsules, Cotellic, Sutent 25 mg hard capsules, RO7047650, Cotellic, Alecensa 150 mg hard capsules, Tecentriq 1 200 mg concentrate for solution for infusion, Zelboraf, Sutent 12.5 mg hard capsules, Venclexta, Venclyxto, Alecensa 150 mg hard capsules, Paclitaxel 6 mg/ml Concentrate for Solution for Infusion, RO7250726, Sutent 25 mg hard capsules, ALIMTA 500 mg powder for concentrate for solution for infusion, Sutent 50 mg hard capsules, Zelboraf

Primary endpoint: Patients who are deriving clinical benefit from the treatment with atezolizumab-based therapy and/or comparator agent(s) according to investigator assessment.

Source: https://euclinicaltrials.eu/ctis-public/view/2023-506184-34-00